EU clinical trial 2024-518950-17-00: A prospective, randomized, double- blind, placebo- controlled study to evaluate the efficacy of Landiolol hydrochloride for prevention of atrial fibrillation in patients undergoing cardiac surgery
Protocol code: Version: 2.1
Sponsor: Medical University Of Vienna (Educational Institution). Phase: Therapeutic confirmatory (Phase III). Countries: Austria (ongoing, recruiting).
Therapeutic area(s): Analytical, Diagnostic and Therapeutic Techniques and Equipment [E] - Therapeutics [E02]
Gender: Female, Male. Age: 18-64 years, 65+ years. Enrolment: 164.
Status: Ongoing, recruiting. Start date (EU): 2021-10-18. Decision date: 2025-01-27. Results received: No. Last updated: 2025-01-27.

Condition(s): Beta-blocker intake, Normal left ventricular ejection fraction, Sinus rhythm
Product: Isotone Natriumchloridlösung 0.9% Braun Injektionslösung; Isotone Kochsalzlösung 0,9 % von BBraun BBraun Isotone Kochsalzlösung NaCl 0,9 % - in der praktischen Ecoflac® Plus PE-Flasche; BBraun Isotone Kochsalzlösung 0,9 % Produktmerkmale: - Isotone Kochsalzlösung 0,9%; - In der ecoflac® plus PE-Flasche; - mit 2 Einstechmöglichkeiten und Aufhängung am Flaschenboden; - kann an allen gängigen Infusionsständern befestigt werden; - in verschiedenen Größen erhältlich; Anwendungsgebiete: - Trägerlösung für Elektrolytkonzentrate und kompatible Medikamente; - Flüssigkeits- und Elektrolytsubstitution bei hypochlorämischer Alkalose; - Chloridverluste; - kurzfristiger intravasaler Volumenersatz; - hypotone Dehydratation; - zur Wundbehandlung und zur Befeuchtung von Tüchern und Verbänden; Dosierung: Die Dosierung richtet sich nach dem Flüssigkeits- und Elektrolytbedarf. Zusammensetzung: Der Wirkstoff ist Natriumchlorid. 1000 ml Infusionslösung enthalten 9,0 g Natriumchlorid. Der sonstige Bestandteil ist Wasser für Injektionszwecke. Wirkstoffe: Natriumchlorid, Natrium-Ion, Chlorid, Rapibloc 300 mg Pulver zur Herstellung einer Infusionslösung

Primary endpoint: The primary end point is a combined endpoint consisting of the occurrence of atrial fibrillation and mortality during the initial 72 hours period after surgery.
Endpoint(s): Occurrence of atrial fibrillation during the initial seven days after surgery • Initiation of standard of care for atrial fibrillation because of postoperative atrial fibrillation • Hemodynamic stability assessed by systolic blood pressure, diastolic blood pressure, and heart rate (in patients on pacing, the pacemaker will be stopped before measurement of blood pressure and heart rate) at time of admission to the intensive care unit (ICU), at 24, 48 and 72 hours and 7 days after administr

Source: https://euclinicaltrials.eu/ctis-public/view/2024-518950-17-00